EU clinical trial 2023-505511-20-00: Phase I/II Trial to Determine Persistence, Safety and Clinical Activity of Allogeneic CIK Cells Transduced with a Transposon CD19-chimeric Antigen Receptor (CARCIK-CD19) in Adult and Pediatric Patients with Relapsed/Refractory B-cell Non-Hodgkin Lymphoma and B-cell Chronic Lymphocytic Leukemia
Protocol code: FT04CARCIK
Sponsor: Fondazione Tettamanti (Laboratory/Research/Testing facility). Phase: Phase I and Phase II (Integrated)- Other. Countries: Italy (ongoing, recruiting).
Therapeutic area(s): Diseases [C] - Hemic and Lymphatic Diseases [C15]
Gender: Female, Male. Age: 0-17 years, 18-64 years, 65+ years. Enrolment: 38.
Status: Ongoing, recruiting. Start date (EU): 2024-01-29. Decision date: 2023-11-23. Results received: No. Last updated: 2026-05-18.

Condition(s): B-Non Hodgkin Lymphoma and Chronic Lymphocytic Leukemia
Product: PTG-CARCIK-CD19

Primary endpoint: Phase I • DLT as per investigator assessment during the first 28 days after CARCIK-CD19 infusion [population: patients treated with CARCIK-CD19] Phase II • Investigator-assessed overall response rate (complete + partial remission) at month 3 after CARCIK-CD19 infusion according to 2014 Lugano criteria (iwCLL 2018 criteria for CLL). [population: patients treated with CARCIK-CD19]
Endpoint(s): • Incidence of Adverse event (AE) and laboratory abnormalities continuously assessed throughout the study and reported at each scheduled visit. Description and grading of all adverse events will be based on the NCI –CTCAE and MedDRA code (current version) • Persistence and kinetics of CARCIK-CD19 cells in target tissues (blood, bone marrow, and other tissues if available)

Source: https://euclinicaltrials.eu/ctis-public/view/2023-505511-20-00